EU clinical trial 2023-504454-35-00: A RANDOMIZED PHASE 3 DOUBLE-BLINDED STUDY COMPARING THE EFFICACY AND SAFETY OF NIRAPARIB TO PLACEBO IN PARTICIPANTS WITH EITHER HER2-NEGATIVE BRCA-MUTATED OR TRIPLE-NEGATIVE BREAST CANCER WITH MOLECULAR DISEASE BASED ON PRESENCE OF CIRCULATING TUMOR DNA AFTER DEFINITIVE THERAPY (ZEST)
Protocol code: 213831
Sponsor: Glaxosmithkline Research & Development Limited (Pharmaceutical company). Phase: Therapeutic confirmatory (Phase III). Countries: Spain (ended), Poland (ongoing, recruitment ended), Netherlands (ongoing, recruitment ended), Italy (ended).
Therapeutic area(s): Diseases [C] - Neoplasms [C04]
Gender: Female, Male. Age: 18-64 years, 65+ years. Enrolment: 143.
Start date (EU): 2021-06-22. Decision date: 2024-08-05. Results received: No. Last updated: 2026-04-09.
Decision dates by country: IT: 2024-08-12, ES: 2024-08-05, NL: 2024-08-05, PL: 2024-08-09

Condition(s): Neoplasms, Breast
Product: Niraparib Placebo Tablets

Primary endpoint: "Primary End Point - The incidence of TEAEs, SAEs, and AESIs; TEAEs leading to death, TEAEs leading to dose modifications, and TEAEs leading to discontinuation will be assessed. Clinically relevant laboratory parameters, vital signs, ECOG performance status, and use of concomitant medications will be collected and evaluated as defined in the Statistical Analysis Plan (SAP)"

Source: https://euclinicaltrials.eu/ctis-public/view/2023-504454-35-00